EU clinical trial 2023-505252-21-00: A 2-Part, Open-Label, Phase 2, Multiple Dose Study to Evaluate the Pharmacodynamic Effects, Safety, and Tolerability of Patiromer in Children under 12 Years of Age with Hyperkalaemia (EMERALD2)
Protocol code: RLY5016-208p
Sponsor: Vifor Pharma Inc. (Pharmaceutical company). Phase: Therapeutic exploratory (Phase II). Countries: Slovakia (ended), Greece (authorised, recruiting), France (ongoing, recruiting), Hungary (ended), Belgium (authorised, recruiting), Finland (authorised, recruitment pending), Italy (authorised, recruiting), Portugal (authorised, recruiting), Norway (authorised, recruiting), Romania (ongoing, recruiting), Poland (authorised, recruitment pending).
Therapeutic area(s): Diseases [C] - Nutritional and Metabolic Diseases [C18]
Gender: Female, Male. Age: 0-17 years. Enrolment: 26.
Start date (EU): 2025-02-14. Decision date: 2023-08-10. Results received: No. Last updated: 2026-06-17.
Decision dates by country: HU: 2023-09-01, SK: 2023-08-22, PL: 2025-08-04, RO: 2025-06-30, BE: 2025-02-05, FR: 2023-08-10, FI: 2025-02-14, IT: 2025-01-27, PT: 2025-04-29, NO: 2025-02-03, GR: 2023-08-10

Condition(s): Hyperkalemia
Product: Patiromer 1g Powder for oral suspension, Patiromer 2g Powder for oral suspension

Primary endpoint: Changes in potassium levels from baseline to Day 28.
Endpoint(s): Changes in potassium levels from baseline to Day 3, Day 7, and Day 14 and end of the study Part 1 and during the optional safety-extension period., Occurrence of TEAEs and SAEs., Change in vital signs, 12-lead ECG, and clinical safety laboratory evaluations., Laboratory safety endpoints of special interest including occurrence of blood potassium: − Below the LLN. − Above the ULN, Occurrence of blood magnesium: − <1.4 mg/dl (<0.58 mmol/l) − <1.2 mg/dl (<0.49 mmol/l) − <1.0 mg/dl (<0.41 mmol/l), Occurrence of serum calcium, phosphate, fluoride, creatinine, bicarbonate, and blood urea nitrogen levels that are outside of normal range of the respective age.

Source: https://euclinicaltrials.eu/ctis-public/view/2023-505252-21-00